EU clinical trial 2024-513759-34-00: A Phase 1/2, Open-label, Dose-Escalation and Dose-Expansion Cohort Study of SNDX-5613 in Patients with Relapsed/Refractory Leukemias, Including Those Harboring an MLL/KMT2A Gene Rearrangement or Nucleophosmin 1 (NPM1) Mutation.
Protocol code: SNDX-5613-0700
Sponsor: Syndax Pharmaceuticals Inc. (Pharmaceutical company). Phase: Phase I and Phase II (Integrated)- First administration to humans. Countries: Spain (ongoing, recruiting), Lithuania (ongoing, recruiting), Germany (ongoing, recruiting), Italy (ongoing, recruiting), France (ongoing, recruiting), Netherlands (ongoing, recruitment ended).
Therapeutic area(s): Diseases [C] - Neoplasms [C04]
Gender: Female, Male. Age: 0-17 years, 18-64 years, 65+ years. Enrolment: 67.
Start date (EU): 2022-05-31. Decision date: 2024-07-24. Results received: No. Last updated: 2026-03-02.
Decision dates by country: FR: 2024-08-23, DE: 2024-07-30, IT: 2024-07-30, LT: 2024-08-13, ES: 2024-07-24, NL: 2024-07-25

Condition(s): Relapsed or Refractory Acute Leukemias
Product: Revumenib, Revumenib, SNDX-5613, Revumenib, Revumenib, SNDX-5613

Primary endpoint: Phase 1: Occurrence of dose-limiting toxicities (DLTs)., Phase 1: Frequency, duration, and severity of treatment-emergent adverse events (TEAEs), treatment-related TEAEs (TRAEs), and serious adverse events (SAEs)., Phase 1: Incidence and shifts of clinically significant clinical laboratory abnormalities., Phase 1: Change from baseline in other observations related to safety, including electrocardiograms (ECGs), vital signs, ophthalmologic examination findings, and performance status., Phase 1: Pharmacokinetic (PK) parameters: maximum plasma concentration (Cmax), time to maximum plasma concentration (Tmax), area under the plasma concentration versus time curve (AUC) from time 0 to t (AUC0–t), AUC from time 0 to 24 hours (AUC0–24), apparent oral clearance (CL/F), apparent volume of distribution (Vz/F), and half-life (t1/2)., Phase 2: Cohorts 2A-2C: • CR+CRh rate. • Frequency, duration, and severity of TEAEs, TRAEs, and SAEs. • Incidence and shifts of clinically significant clinical laboratory abnormalities., Phase 2: Cohorts 2A-2C: Change from baseline in other observations related to safety, including ECGs, vital signs, and performance status., Phase 2: Cohort 2D: • Endpoints defined in protocol.
Endpoint(s): Phase 1: • PK parameters., Phase 2: Cohorts 2A-2C: • Transfusion independence, defined as any transfusion-free period lasting for at least 56 consecutive days, during which the patient is either on SNDX-5613 therapy or after cessation of SNDX-5613 therapy but prior to the start of new therapy., Phase 2: Cohorts 2A-2C: • CRc rate (ie, CR+CRh+CRi+CRp). • ORR (CRc+MLFS+PR). • Time to response. • Duration of response. • Event free survival. • Overall survival. • PK parameters.

Source: https://euclinicaltrials.eu/ctis-public/view/2024-513759-34-00